EU clinical trial 2025-522059-24-00: Nitraattien vaikutus matalapaineglaukoomassa
Sponsor: University Of Helsinki (Educational Institution). Phase: Therapeutic use (Phase IV). Countries: Finland (authorised, recruitment pending).
Therapeutic area(s): Diseases [C] - Eye Diseases [C11]
Gender: Female, Male. Age: 18-64 years, 65+ years. Enrolment: 100.
Status: Authorised, recruitment pending. Decision date: 2025-11-06. Results received: No. Last updated: 2025-11-06.

Condition(s): Normal tension glaucoma
Product: 9mm tabletti, YA tuotekoodi 80746, Ismox 20 mg tabletti

Primary endpoint: Tutkimuskäyntien yhteydessä tutkitaan näköhermonnystyn hermosäiepaksuus valokerroskuvaus -menetelmällä. Ryhmien välistä eroa tarkastellaan ensisijaisesti näköhermonnystyn hermosäiepaksuuden muutoksella suhteessa seuranta-aikaan (muutosnopeus per vuosi). Ensisijainen päätetapahtuma on muutos tutkimuslääkityksen aloittamisesta seurannan loppuun (18 kk). 6 ja 12 kuukauden kohdalla mitattavat muutokset ovat väliaikapisteitä, eivät päätetapahtumia.
Endpoint(s): Hoitoryhmien tuloksia vertaillaan toissijaisesti näkökentän MD-arvojen muutoksena suhteessa seuranta-aikaan, glaukooman paikallislääkityksen tehostamisen tai glaukooman pientoimenpide (selektiivinen lasertrabekuloplastia) / leikkaushoidon tarpeena seuranta-aikana. Toissijaiset päätetapahtumat analysoidaan 18 kk:n kohdalla. 6 ja 12 kuukauden kohdalla mitattavat muutokset ovat väliaikapisteitä, eivät päätetapahtumia., Hoitoryhmien tuloksia vertaillaan hoidon siedettävyyden ja haittavaikutusten näkökulmasta (subjektiivinen oirepäiväkirja). Toissijaiset päätetapahtumat analysoidaan 18 kk:n kohdalla. 6 ja 12 kuukauden kohdalla mitattavat muutokset ovat väliaikapisteitä, eivät päätetapahtumia.

Source: https://euclinicaltrials.eu/ctis-public/view/2025-522059-24-00